EU clinical trial 2023-509387-24-00: “A randomized phase II trial to evaluate the antitumor activity of Enzalutamide and Talazoparib (PF-06944076) for the treatment of metastatic hormone-naïve prostate cancer”
Protocol code: MEDOPP234
Sponsor: Medica Scientia Innovation Research S.L. (Pharmaceutical company). Phase: Therapeutic exploratory (Phase II). Countries: Spain (ended).
Therapeutic area(s): Diseases [C] - Neoplasms [C04]
Gender: Male. Age: 18-64 years, 65+ years. Enrolment: 54.
Status: Ended. Start date (EU): 2020-09-02. End date (EU): 2025-05-06. Decision date: 2024-08-20. Results received: Yes. Last updated: 2025-05-05.

Condition(s): Metastatic hormone–naïve prostate cancer (mHNPC)
Product: Talzenna 0.25 mg hard capsules, Talzenna 0.1 mg hard capsules, Xtandi - 40 mg film-coated tablets

Primary endpoint: PSA-CR defined as the percentage of patients with PSA < 0.2 ng/mL at month 12 of therapy.
Endpoint(s): Rate of PSA complete response (CR) at any time point and at month 7 (<0.2 ng/mL), PSA response (< 4ng/ml) at 7 and 12 months, PSAprogression-free survival (PSA-PFS) based on Prostate Cancer Working Group 3 (PCWG3) criteria (PSA ≥ 25% and ≥ 2 ng/mL from nadir confirmed by a second value obtained 3 or more weeks later),, radiologic PFS (rPFS) based on Response Evaluation Criteria in Solid Tumors (RECIST) version (v.)1.1, time to castration resistance (TTCR), based on PSA-PFS and RECIST rPFS, and overall survival (OS), Incidence of adverse events (AEs), incidence of prespecified AEs as per National Cancer Insitute’s Common Terminology Criteria for Adverse Events (CTCAE) v.5.0, change from baseline in targeted vital signs, and change from baseline in targeted clinical laboratory test results.

Source: https://euclinicaltrials.eu/ctis-public/view/2023-509387-24-00